EU clinical trial 2025-523501-15-00: A Phase 2, monocentric, prospective, nonrandomized, open-label, experimental study to evaluate efficacy and safety of intrabronchial instillation of liposomal Amphotericin B in patients with simple pulmonary aspergilloma.
Protocol code: BRO-LAMB
Sponsor: Pauls Stradins Clinical University Hospital (Hospital/Clinic/Other health care facility). Phase: Therapeutic exploratory (Phase II). Countries: Latvia (authorised, recruitment pending).
Therapeutic area(s): Diseases [C] - Respiratory Tract Diseases [C08]; Diseases [C] - Bacterial Infections and Mycoses [C01]
Gender: Female, Male. Age: 18-64 years, 65+ years. Enrolment: 20.
Status: Authorised, recruitment pending. Decision date: 2026-03-13. Results received: No. Last updated: 2026-03-13.

Condition(s): Simple aspergilloma
Product: AmBisome liposomāls amfotericīns B 50 mg pulveris infūziju šķīduma pagatavošanai

Primary endpoint: Relative change in lesion (aspergilloma) size, expressed as a percentage from baseline to post-treatment.
Endpoint(s): The proportion of patients in each treatment response category based on changes in aspergilloma (mycetoma) size from baseline to Week 8 visit, categorized as complete response (complete absorption of the lesion, 100% reduction in size), partial response (≥ 50% reduction in lesion size) and insufficient response (< 50% reduction or no change in lesion size)., Proportion of patients with adverse events categorized by severity as mild, moderate or severe during treatment with intrabronchial instillation of liposomal Amphotericin B., The proportion of patients with change shift on the COPD Assessment Test (CAT) score from baseline to post-treatment assessment visit., The proportion of patients with disease progression during study treatment, defined as an increase in the size of aspergilloma (mycetoma) or progression to other forms of chronic pulmonary aspergillosis – chronic cavitary or fibrosing pulmonary aspergillosis, invasive pulmonary aspergillosis., Proportion of patients with hemoptysis during study treatment, categorized by severity as mild, moderate and severe.

Source: https://euclinicaltrials.eu/ctis-public/view/2025-523501-15-00